EU clinical trial 2024-516890-63-00: The impact of psilocybin on pain in fibromyalgia patients: a multicenter trial
Sponsor: Universiteit Maastricht (Educational Institution). Phase: Therapeutic exploratory (Phase II). Countries: Netherlands (ongoing, recruitment ended).
Therapeutic area(s): Diseases [C] - Musculoskeletal Diseases [C05]
Gender: Female, Male. Age: 18-64 years. Enrolment: 35.
Status: Ongoing, recruitment ended. Start date (EU): 2025-01-21. Decision date: 2025-01-21. Results received: No. Last updated: 2025-08-14.

Condition(s): Fibromyalgia
Product: microcrystalline cellulose capsule, Psilocybin

Primary endpoint: We hypothesize that psilocybin will induce significant analgesic effects at 5 mg and 10 mg compared to placebo as measured by subjective measures and the outcomes of the PPT and CPT. We also hypothesize that these potential effects will be associated with variations in BDNF levels.
Endpoint(s): The secondary objective is to assess the impact of low psilocybin doses on mood, cognition, personality, autobiographical memory functioning and psychedelic experience. We will also test whether hypnotic suggestions can moderate the potential effects of psilocybin on pain perception and tolerance. Finally, we will test whether the plasma levels of inflammatory biomarkers (IL-1α, IL-1β, IL-6, IL-8, and TNF-α, C-reactive protein (CRP)) will decrease in response to psilocybin administration.

Source: https://euclinicaltrials.eu/ctis-public/view/2024-516890-63-00